EU clinical trial 2023-506047-41-00: RANDOMISED, CROSSOVER BIOEQUIVALENCE CLINICAL TRIAL OF LINAGLIPTIN 5 MG FILM-COATED TABLETS, AFTER A SINGLE ORAL DOSE ADMINISTRATION TO HEALTHY VOLUNTEERS UNDER FASTING CONDITIONS
Protocol code: UECHUP-LIN/23-3
Sponsor: Laboratorios Alter S.A. (Pharmaceutical company). Phase: Human Pharmacology (Phase I)- Bioequivalence Study. Countries: Spain (ended).
Therapeutic area(s): Diseases [C] - Nutritional and Metabolic Diseases [C18]
Gender: Female, Male. Age: 18-64 years. Enrolment: 36.
Status: Ended. Start date (EU): 2023-11-07. End date (EU): 2023-12-22. Decision date: 2023-08-10. Results received: Yes. Last updated: 2023-11-06.

Condition(s): diabetes
Product: Trajenta 5 mg film-coated tablets, Linagliptina 5 mg Comprimido recubierto

Primary endpoint: AUC0-72 and Cmax of linagliptin.
Endpoint(s): AUC0-∞, Tmax and residual area of linagliptin.

Source: https://euclinicaltrials.eu/ctis-public/view/2023-506047-41-00